EU clinical trial 2023-509738-20-00: A Phase 4 Multicenter, Randomized, Open-label, Efficacy Assessor-blinded-Study of Risankizumab Compared to Deucravacitinib for the Treatment of Adult Subjects with Moderate Plaque Psoriasis who are Candidates for Systemic Therapy
Protocol code: M24-541
Sponsor: AbbVie Deutschland GmbH & Co. KG (Pharmaceutical company). Phase: Therapeutic use (Phase IV). Countries: Hungary (ended), Germany (ended), Greece (ended), Italy (ended), Netherlands (ended), Belgium (ended), Spain (ended).
Therapeutic area(s): Diseases [C] - Skin and Connective Tissue Diseases [C17]
Gender: Female, Male. Age: 18-64 years, 65+ years. Enrolment: 150.
Status: Ended. Start date (EU): 2024-07-11. End date (EU): 2026-03-12. End date: 2026-03-19. Decision date: 2024-07-03. Results received: No. Last updated: 2026-01-30.
Decision dates by country: NL: 2024-09-23, ES: 2024-07-05, IT: 2024-07-04, HU: 2024-07-03, GR: 2024-07-04, DE: 2024-07-08, BE: 2024-07-03

Condition(s): Plaque Psoriasis
Product: ABBV-066, DEUCRAVACITINIB

Primary endpoint: Period A: Achievement of PASI 100 at Week 16, Period A: Achievement of sPGA 0 with at least 2-grade improvement from Baseline at Week 16, Period B, to be analyzed among subjects switching from deucravacitinib to risankizumab after failing to achieve PASI 90 at Week 16 (ITT_B_NR Population): Achievement of PASI 90 at Week 52
Endpoint(s): Period A: Achievement of PASI 100 at Week 16, Period A: Achievement of sPGA 0 with at least 2-grade improvement from Baseline at Week 16, Period B, to be analyzed among subjects switching from deucravacitinib to risankizumab after failing to achieve PASI 90 at Week 16 (ITT_B_NR Population): Achievement of PASI 100 at Week 52, among subjects, Period B, to be analyzed among subjects switching from deucravacitinib to risankizumab after failing to achieve PASI 90 at Week 16 (ITT_B_NR Population): Achievement of sPGA 0 with at least 2-grade improvement from Baseline at Week 52, among subjects

Source: https://euclinicaltrials.eu/ctis-public/view/2023-509738-20-00